EU clinical trial 2022-502586-21-00: Clinical and endocrinological effects of letrozole during the luteal phase after controlled ovarian stimulation in oocyte donors: a low interventional, randomized, controlled trial
Protocol code: 2206-MAD-089-SC
Sponsor: Ivi Madrid S.L. (Hospital/Clinic/Other health care facility). Phase: Therapeutic confirmatory (Phase III). Countries: Spain (ended).
Therapeutic area(s): Phenomena and Processes [G] - Reproductive and Urinary Physiological Phenomena [G08]
Gender: Female. Age: 18-64 years. Enrolment: 152.
Status: Ended. Start date (EU): 2023-12-04. End date (EU): 2025-06-02. Decision date: 2023-03-17. Results received: No. Last updated: 2024-06-25.

Condition(s): Female Infertility
Product: LETROZOLE

Primary endpoint: ovarian volume
Endpoint(s): Plasma values of VEGF, sFlt-1, oestradiol, progesterone, FSH, LH and testosterone

Source: https://euclinicaltrials.eu/ctis-public/view/2022-502586-21-00